EU clinical trial 2025-521223-78-00: A Study of Intravesical Bacillus Calmette-Guerin (BCG) in Combination With ALT-803 (N-803) in Patients With Non-Muscle Invasive Bladder Cancer
Protocol code: QUILT-2.005
Sponsor: Immunitybio Inc. (Pharmaceutical company). Phase: Therapeutic exploratory (Phase II). Countries: Germany (ended).
Therapeutic area(s): Diseases [C] - Neoplasms [C04]
Gender: Female, Male. Age: 18-64 years, 65+ years. Enrolment: 50.
Status: Ended. End date (EU): 2026-02-05. Decision date: 2025-08-26. Results received: No. Last updated: 2025-12-03.
Decision dates by country: DE: 2025-10-13

Condition(s): Non-Muscle Invasive Bladder Cancer
Product: OncoTICE® powder for instillation fluid for intravesical use containing 2-8 x 108 CFU Tice BCG., N-803 (NAI), OncoTICE® 2-8 x 108 vermehrungsfähige Einheiten Pulver zur Herstellung einer Suspension zur intravesikalen Instillation

Primary endpoint: Cohort A: Comparison of the CR rate at 6 months for patients treated with N-803 plus BCG versus patients treated with BCG alone. Cohort B: The estimate of the median DFS will be provided for each treatment group along with the 95% confidence interval. Cohort A and B: Due to the allocation of a small amount of alpha to the unplanned interim efficacy analyses, the final primary efficacy analyses will be conducted at alpha level of 0.0499.
Endpoint(s): Cohort A 1. Duration of CR 2. CR rate at 3, 9, 12, 18, 24, 30, and 36 months Cohort B 1. DFS rate at 3, 9, 12, 18, 24, 30, and 36 months. Cohort A 1. CR rate at 3, 9, 12, 18, 24, 30, and 36 months (all recurrent bladder cancer including low grade Ta disease) 2. Duration of CR (all recurrent bladder cancer, including low grade Ta disease).

Source: https://euclinicaltrials.eu/ctis-public/view/2025-521223-78-00